EU clinical trial 2024-512960-75-00: A phase III clinical trial of adjuvant treatment with Sacituzumab and Zimberelimab for stage IB-IIIA-IIIB (N2) previously resected (R0) non-small cell lung cancer (NSCLC) patients that did not achieve pathological complete response after neoadjuvant treatment (ARIAN)
Protocol code: GECP 23/03
Sponsor: Fundacion GECP (Patient organisation/association). Phase: Therapeutic confirmatory (Phase III). Countries: Spain (ongoing, recruiting).
Therapeutic area(s): Diseases [C] - Neoplasms [C04]
Gender: Female, Male. Age: 18-64 years, 65+ years. Enrolment: 129.
Status: Ongoing, recruiting. Start date (EU): 2025-02-04. Decision date: 2024-08-19. Results received: No. Last updated: 2026-03-09.

Condition(s): Resectable Non-small cell lung cancer
Product: Trodelvy 200 mg powder for concentrate for solution for infusion, Zimberelimab

Primary endpoint: The primary objective is to evaluate the disease-free survival (DFS): defined as the length of time from randomization to the earliest event defined as disease recurrence, any new lung cancer (even in the opposite lung), or death from any cause at any known point in time.
Endpoint(s): 1. Overall survival (OS): at 12, 24 and 36 months after the start of adjuvant treatment, 2. Safety and tolerability of the combination of Sacituzumab Govitecan + Zimberelimab according to CTCAE v5.0

Source: https://euclinicaltrials.eu/ctis-public/view/2024-512960-75-00